EU clinical trial 2023-508777-91-00: A Phase 2/3, Multicenter, Randomized, Double-blind Study to Evaluate the Efficacy, Safety, Pharmacokinetics and Pharmacodynamics of Oral Ozanimod (RPC1063) in Pediatric Participants with Moderately to Severely Active Crohn’s Disease with an Inadequate Response to Conventional Therapy
Protocol code: IM047-023
Sponsor: Celgene International II S.a.r.l. (Pharmaceutical company). Phase: Phase II and Phase III (Integrated). Countries: France (ended), Poland (ended), Spain (ended), Germany (ended), Hungary (ended), Belgium (ended).
Therapeutic area(s): Diseases [C] - Digestive System Diseases [C06]
Gender: Female, Male. Age: 0-17 years. Enrolment: 50.
Status: Ended. Start date (EU): 2023-05-16. End date (EU): 2024-09-13. End date: 2024-09-14. Decision date: 2024-02-01. Results received: Yes. Last updated: 2024-10-07.
Decision dates by country: DE: 2024-06-04, PL: 2024-02-19, ES: 2024-02-02, HU: 2024-06-04, BE: 2024-06-04, FR: 2024-02-01

Condition(s): Moderately to Severely Active Crohn's Disease
Product: Zeposia 0.23 mg hard capsules; Zeposia 0.46 mg hard capsules, Zeposia 0.23 mg hard capsules Zeposia 0.46 mg hard capsules, Zeposia 0.92 mg hard capsules

Primary endpoint: Proportion of participants who achieve PCDAI < 10 at Week 64 Proportion of participants achieving SES-CD ≤ 2 or SES-CD ≤ 4 points with no SES-CD subscore > 1 point at Week 64
Endpoint(s): Proportion of participants who achieve PCDAI < 10 at Week 12

Source: https://euclinicaltrials.eu/ctis-public/view/2023-508777-91-00